EU clinical trial 2024-511734-13-04: Is the glucagon-like peptide-1 receptor agonist semaglutide able to alleviate mood in patients with major depressive disorder and overweight or obesity? Sema-Mood.
Sponsor: Region Hovedstaden (Hospital/Clinic/Other health care facility). Phase: Phase III and phase IV (Integrated). Countries: Denmark (ongoing, recruiting).
Therapeutic area(s): Psychiatry and Psychology [F] - Mental Disorders [F03]
Gender: Female, Male. Age: 18-64 years. Enrolment: 120.
Status: Ongoing, recruiting. Start date (EU): 2025-05-15. Decision date: 2025-05-07. Results received: No. Last updated: 2025-12-23.

Condition(s): Unipolar depression Overweight and obesity, Obesity and overweight
Product: Wegovy 1 mg solution for injection in pre-filled pen, Saline Solution Basi 9 mg/ml solution for infusion, Wegovy 0.5 mg solution for injection in pre-filled pen, Wegovy 2.4 mg solution for injection in pre-filled pen, Wegovy 1.7 mg FlexTouch solution for injection in pre-filled pen, Wegovy 0.25 mg solution for injection in pre-filled pen

Primary endpoint: The primary outcome will be change in Major Depression Inventory from baseline to end of study
Endpoint(s): Secondary outcomes include changes in body weight, hip and waist circumference, hemoglobin A1c lean and fat body mass and bone density, biomarkers related to inflammation, and oxidative stress and further overall functioning, quality of life, perceived stress, and cognitive scores

Source: https://euclinicaltrials.eu/ctis-public/view/2024-511734-13-04